EU clinical trial 2024-512647-23-00: A Proof-of-Concept, Open-label Study to Assess the Safety and Efficacy of Batoclimab in Participants with Graves’ Disease (GD)
Sponsor: Immunovant Sciences GmbH (Pharmaceutical company). Phase: Therapeutic exploratory (Phase II). Countries: Germany (ended).
Therapeutic area(s): Diseases [C] - Immune System Diseases [C20]
Gender: Female, Male. Age: 18-64 years, 65+ years. Enrolment: 35.
Status: Ended. Start date (EU): 2023-06-14. End date (EU): 2025-07-25. Decision date: 2024-09-23. Results received: Yes. Last updated: 2025-02-17.

Condition(s): Grave's disease
Product: Batoclimab

Primary endpoint: Proportion of participants who, at Week 24, without increase in ATD dose compared to baseline, have achieved normalization of FT3 and FT4, or have FT3 and/or FT4 below the LLN.
Endpoint(s): Proportion of participants who achieve normalization of FT3 and FT4 at Week 24 with ATD dose ≤50% of the baseline ATD dose by Week 24., Proportion of participants who are off ATD treatment and achieve normalization of FT3 and FT4, or have FT3 and/or FT4 below the LLN at Week 24.

Source: https://euclinicaltrials.eu/ctis-public/view/2024-512647-23-00